EU clinical trial 2023-507623-36-00: TherVacB – A multi-center phase 1b/2a trial to assess safety, tolerability and immunogenicity of a heterologous protein prime/MVA boost therapeutic hepatitis B vaccine candidate
Protocol code: TherVacB_1b2a_1
Sponsor: Klinikum der Universitaet Muenchen AöR (Hospital/Clinic/Other health care facility). Phase: Phase I and Phase II (Integrated)- Other. Countries: Germany (ongoing, recruiting), Spain (authorised, recruitment pending).
Therapeutic area(s): Diseases [C] - Virus Diseases [C02]
Gender: Female, Male. Age: 18-64 years, 65+ years. Enrolment: 69.
Start date (EU): 2025-05-26. Decision date: 2024-05-13. Results received: No. Last updated: 2026-08-06.
Decision dates by country: DE: 2024-05-13, ES: 2026-08-06

Condition(s): Chronic hepatitis B

Primary endpoint: Frequencies and magnitudes of unsolicited adverse events, Frequencies and magnitudes of serious adverse events (SAEs), Frequencies and magnitudes of adverse events of special interest (AESI) and Suspected Unexpected Serious Adverse Reactions (SUSAR), Frequencies and magnitudes of solicited local reactogenicity signs and symptoms within 7 days after each vaccination, Frequencies and magnitudes of solicited systemic reactogenicity signs and symptoms within 7 days after each vaccination, Frequencies and magnitudes of liver toxicity (ALT flare-ups) stratified by severity, Change from baseline of safety laboratory measurements
Endpoint(s): Frequency of subjects with HBsAg drop below the lower limit of quantification, Frequency of subjects with a ≥ 1 log10 drop in HBsAg titers from day 0 (start of study medication) with the goal of 30% of patients achieving a ≥ 1log10 HBsAg drop, Frequency of subjects with an induction of anti-HBs titers ≥10 IU/L, Frequency of subjects developing any anti-HBs antibody response, Frequency of subjects with an increased signal in the HBV-specific cytokine-secretion assay compared to pretreatment values, Frequency of subjects with an increased frequency of total HBV-specific, cytokine-secreting T cells compared to pretreatment values, Frequency of subjects developing an immune response to TherVacB treatment arms A5, A6 or B4 with the goal of ≥ 30% of patients developing anti-HBs antibody or T-cell responses

Source: https://euclinicaltrials.eu/ctis-public/view/2023-507623-36-00